EU clinical trial 2024-513039-26-00: Prospective Phase-II Trial of induction chemotherapy and chemoradiotherapy plus/minus the PD-L1 antibody durvalumab followed by surgery or definitive chemoradiation boost and consolidation durvalumab in resectable stage III NSCLC (ESPADURVA)
Protocol code: ESPADURVA
Sponsor: Universitaetsklinikum Essen AöR (Hospital/Clinic/Other health care facility). Phase: Therapeutic exploratory (Phase II). Countries: Germany (ongoing, recruitment ended).
Therapeutic area(s): Diseases [C] - Neoplasms [C04]
Gender: Female, Male. Age: 18-64 years, 65+ years. Enrolment: 90.
Status: Ongoing, recruitment ended. Start date (EU): 2019-11-25. Decision date: 2024-08-26. Results received: No. Last updated: 2025-09-22.

Condition(s): non-small cell lung cancer stages IIIA (N2) and selected resectable stages IIIB
Product: IMFINZI 50 mg/mL concentrate for solution for infusion.

Primary endpoint: The primary endpoint is the progression-free survival rate
Endpoint(s): Overall survival, Occurrence of pulmonary adverse effects of grade > 3 according to CTCAE 5.0., Occurrence of immune therapy related adverse effects of grade > 3 according to CTCAE v.5.0., Adverse events with at least probable relationship to study procedures will counted in total and separate according to CTCAE criteria., Quality of life (QoL C30 and Qol-LC13) date will be analyzed descriptively calculation mean scores, standard deviations median minimum and maximum of the scores.

Source: https://euclinicaltrials.eu/ctis-public/view/2024-513039-26-00